EU clinical trial 2025-524403-80-00: A Phase 3, Randomized, Open-Label, Multicenter Study Evaluating the Efficacy of KITE-753 Versus Axicabtagene Ciloleucel in Participants with Relapsed or Refractory Large B-Cell Lymphoma After First-Line Therapy
Protocol code: KT-US-740-0603
Sponsor: Kite Pharma Inc. (Pharmaceutical company). Phase: Therapeutic confirmatory (Phase III). Countries: Belgium (authorised, recruitment pending), Germany (authorised, recruitment pending), Poland (authorised, recruitment pending), Czechia (authorised, recruitment pending), Netherlands (authorised, recruitment pending), Spain (authorised, recruitment pending), Italy (authorised, recruitment pending), France (authorised, recruitment pending).
Therapeutic area(s): Diseases [C] - Neoplasms [C04]
Gender: Female, Male. Age: 18-64 years, 65+ years. Enrolment: 192.
Status: Authorised, recruitment pending. Decision date: 2026-07-15. Results received: No. Last updated: 2026-08-07.
Decision dates by country: BE: 2026-07-15, DE: 2026-07-20, IT: 2026-07-17, ES: 2026-07-17, NL: 2026-07-16, PL: 2026-07-20, FR: 2026-08-05, CZ: 2026-07-16

Condition(s): Relapsed or refractory large B-cell lymphoma (r/r LBCL)
Product: YESCARTA 0.4 – 2 x 10e8 cells dispersion for infusion, KITE-753

Primary endpoint: Six-month CR rate, defined as the proportion of participants who are in CR at Month 6 postinfusion by the Lugano Classification as determined by blinded central assessment and prior to subsequent anti-lymphoma therapy., Event-free survival (EFS), defined as the time from randomization to the earliest occurrence of the following EFS events, Death due to any cause, Disease progression/relapse per blinded central assessment, Initiation of any non-protocol specified subsequent anti-lymphoma therapy for the treatment of residual disease (including stable disease and partial response as per International Working Group (IWG) Lugano Response Criteria for Malignant Lymphoma {Cheson 2014})., The assessment of residual disease is per investigator and must be confirmed by positron emission tomography-computed tomography or biopsy with pathology review. The timing of this event will be at the time of the earliest disease assessment demonstrating residual disease and leading to subsequent anti-lymphoma therapy, rather than the date of subsequent anti-lymphoma therapy initiation.
Endpoint(s): ORR, as determined by blinded central assessment, PFS, as determined by blinded central assessment, DOR and duration of CR, as determined by blinded central assessment, Incidence of adverse events (AEs) and serious AEs, OS, Changes from screening to post baseline in the European Organisation for Research and Treatment of Cancer Quality of Life (QOL) Questionnaire Cancer-30, Changes from screening to post baseline in the Euro-QOL, Five Dimensions, Five Levels index and visual analog scale scores, Changes from screening to post baseline in the European Organisation for Research and Treatment of Cancer QLQ-NHL-HG29

Source: https://euclinicaltrials.eu/ctis-public/view/2025-524403-80-00